EU clinical trial 2024-515087-31-00: Improved breast cancer therapy (I-BCT-1) in the neoadjuvant and metastatic setting: A phase 2 clinical trial protocol studying biological rationale for the optimal selection of treatment regimens.
Sponsor: Oslo University Hospital HF (Hospital/Clinic/Other health care facility). Phase: Phase I and Phase II (Integrated)- Other. Countries: Norway (ongoing, recruiting).
Therapeutic area(s): Diseases [C] - Pathological Conditions, Signs and Symptoms [C23]
Gender: Female, Male. Age: 18-64 years, 65+ years. Enrolment: 260.
Status: Ongoing, recruiting. Start date (EU): 2024-09-10. Decision date: 2024-09-09. Results received: No. Last updated: 2025-12-17.

Condition(s): Breast cancer
Product: CARBOPLATINE MEDAC 10 mg/mL, solution à diluer pour perfusion

Primary endpoint: The genomic tumor architecture as described by CAAI, and tumor cell heterogeneity before and after treatment as detected and verified by DNA analysis (SNP analysis/sequencing) and quantified by the six CARMA indices.
Endpoint(s): The overall change in the expression (the number and the magnitude of change) of mRNA, and protein in the different treatment groups across timepoints., Changes in the metabolite distribution (individual metabolites and magnitude) as measured by HR-MAS in the different treatment groups., Treatment induced changes and characteristics in circulating tumor DNA and circulating tumor cells in peripheral blood compared to tumor response, Difference in levels of fatigue between treatment arms., Host-related, tumor-related and treatment-related factors predicting chronic fatigue

Source: https://euclinicaltrials.eu/ctis-public/view/2024-515087-31-00